EU clinical trial 2023-505487-11-00: A Phase 3, Multicentre, Randomised, Double-blind, Vehicle-controlled, Parallel-group Study to Evaluate the Efficacy and Safety of Tirbanibulin 10 mg/g Ointment Applied to a Treatment Field Larger Than 25 cm2 and up to 100 cm2 in Adult Patients With Actinic Keratosis
Protocol code: M-14867-33
Sponsor: Almirall S.A. (Pharmaceutical company). Phase: Therapeutic confirmatory (Phase III). Countries: Spain (ended), Netherlands (ended), Poland (ended), Italy (ended), Germany (ended).
Therapeutic area(s): Diseases [C] - Skin and Connective Tissue Diseases [C17]
Gender: Female, Male. Age: 18-64 years, 65+ years. Enrolment: 269.
Status: Ended. Start date (EU): 2023-12-21. End date (EU): 2025-11-25. Decision date: 2023-11-17. Results received: Yes. Last updated: 2025-12-10.
Decision dates by country: PL: 2023-11-20, ES: 2023-11-17, DE: 2023-11-21, NL: 2023-11-20, IT: 2023-11-20

Condition(s): Actinic Keratosis on the Face or Scalp
Product: TIRBANIBULIN, Placebo of the new presentation of 350 mg/sachet drug product (hereafter referred as vehicle) is a smooth, creamy white to off-white ointment free from foreign particles, packed intact and properly sealed containing the same qualitative composition as the active product but without the active substance. The vehicle will be provided in a single-use packets to contain 350 mg of drug product., Klisyri 10 mg/g ointment

Primary endpoint: Percent change from baseline in lesion count at Day 57
Endpoint(s): Proportion of patients with PC at Day 57, defined as ≥75% clearance in the TF at Day 57, Proportion of patients with CC at Day 57, defined as 100% clearance in the TF at Day 57, Proportion of patients with PC by Day 113, defined as 100% clearance in the TF at Day 57 or, for patients receiving a second treatment course, ≥75% clearance at Day 113, Proportion of patients with CC by Day 113, defined as 100% clearance in the TF at Day 57 or, for patients receiving a second treatment course, 100% clearance at Day 113

Source: https://euclinicaltrials.eu/ctis-public/view/2023-505487-11-00